EU clinical trial 2024-514564-13-00: The RIO Trial: A randomised placebo controlled trial of ART plus dual long-acting HIV-specific broadly neutralising antibodies (bNAbs) vs ART plus placebo in treated Primary or Early stage HIV Infection on viral control off ART
Protocol code: 19IC5249
Sponsor: Imperial College London Limited (Educational Institution). Phase: Therapeutic exploratory (Phase II). Countries: Denmark (ongoing, recruiting), Germany (ongoing, recruiting), Spain (ongoing, recruiting), Netherlands (ongoing, recruiting), Sweden (ongoing, recruiting), Belgium (ongoing, recruiting).
Therapeutic area(s): Diseases [C] - Immune System Diseases [C20]; Diseases [C] - Virus Diseases [C02]
Gender: Female, Male. Age: 18-64 years. Enrolment: 21.
Status: Ongoing, recruiting. Start date (EU): 2025-01-02. Decision date: 2025-01-02. Results received: No. Last updated: 2026-08-07.
Decision dates by country: DK: 2025-01-02, DE: 2025-09-11, ES: 2025-09-29, NL: 2025-09-29, SE: 2025-09-03, BE: 2025-11-21

Condition(s): HIV, HIV
Product: 10-1074-LS, 3BNC117-LS, Sodium Chloride 0.9% Intravenous Infusion BP

Primary endpoint: Time to viral rebound within 20 weeks after initial ATI
Endpoint(s): Safety defined as Adverse Events and Serious Adverse Events by group, Length of time undetectable in days following ATI in the absence of detectable ART (Arm A vs B and Arm B Stage 1 ATI vs Stage 2 ATI), CD4 T cell counts and CD4:CD8 ratios at weeks 12, 20, 32 and 44 after randomisation, and 12 weekly until the end of study (Refer to Section 9.13) participation., Percentage of participants with undetectable VL at weeks 12, 24, 36 and 48 post randomisation (Stage 1; Arm A vs B) and then for Arm B participants post second ATI, Quantitation of proviral HIV DNA and cell associated RNA, Duration of remission by different parameters (e.g. VL <40, <400, <1000, +/- blips copies HIV per ml), Time to re-starting ART after start of ATI, Time to undetectable HIV VL after re-starting ART, ART presence in blood during ATI, bNAb levels in blood, bNAb resistance/sensitivity, HIV Quality of Life measure

Source: https://euclinicaltrials.eu/ctis-public/view/2024-514564-13-00